EU clinical trial 2025-521828-30-00: Phase 1/2 Study of PYX-201 in Combination with Pembrolizumab in Advanced Solid Tumors
Protocol code: PYX-201-102
Sponsor: Pyxis Oncology Inc. (Pharmaceutical company). Phase: Phase I and Phase II (Integrated)- Other. Countries: France (ongoing, recruiting), Spain (ongoing, recruiting), Poland (ended).
Therapeutic area(s): Diseases [C] - Neoplasms [C04]
Gender: Female, Male. Age: 18-64 years, 65+ years. Enrolment: 21.
Start date (EU): 2026-01-27. Decision date: 2025-11-19. Results received: No. Last updated: 2026-04-21.
Decision dates by country: FR: 2025-11-19, ES: 2025-11-24, PL: 2025-11-21

Condition(s): Advanced Solid Tumors

Source: https://euclinicaltrials.eu/ctis-public/view/2025-521828-30-00